EU clinical trial 2022-502653-34-01: A phase 3b, interventional, adaptive, clinical trial to evaluate the efficacy and safety of tralokinumab 300 mg every second week monotherapy compared with placebo in subjects with moderate-to-severe atopic hand eczema who are candidates for systemic therapy (ADHAND)
Protocol code: LP0162-2328
Sponsor: LEO PHARMA A/S (Pharmaceutical company). Phase: Phase III and phase IV (Integrated). Countries: Sweden (ended), France (ended), Czechia (ended), Germany (ended), Portugal (ended), Belgium (ended), Netherlands (ended), Spain (ended), Poland (ended).
Therapeutic area(s): Diseases [C] - Skin and Connective Tissue Diseases [C17]
Gender: Female, Male. Age: 18-64 years, 65+ years. Enrolment: 191.
Status: Ended. Start date (EU): 2024-05-30. End date (EU): 2025-09-22. End date: 2025-09-23. Decision date: 2024-01-30. Results received: No. Last updated: 2024-11-20.
Decision dates by country: PL: 2024-05-20, NL: 2024-05-17, DE: 2024-05-17, CZ: 2024-02-01, FR: 2024-02-04, ES: 2024-05-20, SE: 2024-02-02, PT: 2024-01-30, BE: 2024-05-17

Condition(s): Atopic dermatitis and moderate-to severe atopic hand eczema
Product: TRALOKINUMAB, The placebo presentation is a pre-filled syringe containing the same excipients in the same amounts as the IMP.

Primary endpoint: IGA-AHEa score of 0 (clear) or 1 (almost clear) at Week 16.
Endpoint(s): Having a decrease in HECSIb of at least 75% (HECSI-75) from baseline to Week 16, Having a decrease in HECSI of at least 50% (HECSI-50) from baseline to Week 16., Having a decrease in HECSI of at least 90% (HECSI-90) from baseline to Week 16., Percentage change in HECSI score from baseline to Week 16, Having a ≥2-point reduction in IGA-AHE score from baseline to Week 16.

Source: https://euclinicaltrials.eu/ctis-public/view/2022-502653-34-01